EU clinical trial 2024-516060-28-00: A Phase 2 Study of Isatuximab in combination with Pomalidomide and Dexamethasone in MM Patients who received one prior line of therapy containing Lenalidomide and a Proteasome Inhibitor
Protocol code: EAE 115
Sponsor: Hellenic Society Of Hematology (Patient organisation/association). Phase: Therapeutic exploratory (Phase II). Countries: Greece (ongoing, recruitment ended).
Therapeutic area(s): Diseases [C] - Neoplasms [C04]
Gender: Female, Male. Age: 18-64 years, 65+ years. Enrolment: 56.
Status: Ongoing, recruitment ended. Start date (EU): 2022-10-17. Decision date: 2024-11-26. Results received: No. Last updated: 2026-05-13.

Condition(s): Multiple myeloma patients who received one prior line of therapy containing Lenalidomide and a Proteasome Inhibitor"
Product: Isatuximab, DEXAMETHASONE, POMALIDOMIDE, POMALIDOMIDE, POMALIDOMIDE, POMALIDOMIDE, DEXAMETHASONE, Isatuximab

Primary endpoint: The primary endpoint is the ORR at six months of treatment with isatuximab in combination with pomalidomide, and low-dose dexamethasone. ORR is defined as the proportion of patients with stringent complete response (sCR), CR, VGPR, and PR, as assessed by the Investigator using the IMWG response criteria (see Appendix A).
Endpoint(s): Progression-free survival (PFS) is defined as the time from study treatment initiation (Cycle 1, Day 1) to the day of first documentation of PD, as assessed by the Investigator using the IMWG response criteria (see Appendix A), or the date of death from any cause, or initiation of further anti-myeloma treatment, or data cut-off, whichever occurs first., Overall Survival (OS) is defined as the time from study treatment initiation (Cycle 1, Day 1) to the day of death from any cause. OS will be assessed throughout the treatment period and post EOT during long term follow-up visits until the end of the study., Minimal Residual Disease (MRD) negativity is defined as the proportion of patients achieving MRD-negative status, assessed at suspected CR. Time to Response (TTR) is defined as the time from study treatment initiation (Cycle 1, Day 1) to the day of first objective response of PR or better., Duration of Response (DoR) is defined as the time from the day of the first response, as determined by the Investigator, to the day of first PD (based on the IMWG response criteria, see Appendix A) or death, whichever occurs first. DoR will be determined only for patients who have achieved ≥PR, Safety: The incidence of AEs, TEAEs and serious adverse events (SAEs) recorded continuously from ICF until 30 days after last study treatment. AEs and laboratory parameters will be graded using the NCI-CTCAE version 5.0 (see Appendix C) and will be reported in the eCRF, Specific safety laboratory tests are planned in case of infusion reaction (see Study Flow Chart in Section 1.2 and Section 10.9.1). Full details of safety reporting and AE monitoring procedures are provided in Section 10.7.2 and Section 10.10.

Source: https://euclinicaltrials.eu/ctis-public/view/2024-516060-28-00